EU clinical trial 2024-518006-40-00: A Phase III, Multicenter, Randomized, Double-Blind, Placebo-Controlled, Parallel-Group Efficacy and Safety Study of Trontinemab in Participants with Early Symptomatic Alzheimer’s Disease (MCI to Mild Dementia Due to AD)
Protocol code: WN45443
Sponsor: F. Hoffmann-La Roche AG (Pharmaceutical company). Phase: Therapeutic confirmatory (Phase III). Countries: Spain (ongoing, recruitment ended), Poland (ongoing, recruitment ended), Italy (ongoing, recruitment ended), Denmark (ended), France (ongoing, recruitment ended), Germany (ongoing, recruitment ended).
Therapeutic area(s): Diseases [C] - Nervous System Diseases [C10]
Gender: Female, Male. Age: 18-64 years, 65+ years. Enrolment: 265.
Start date (EU): 2025-11-13. Decision date: 2025-11-04. Results received: No. Last updated: 2026-07-28.
Decision dates by country: DK: 2025-11-04, IT: 2025-11-06, DE: 2025-11-18, FR: 2025-11-10, PL: 2025-11-07, ES: 2025-11-07

Condition(s): Early Symptomatic Alzheimer’s Disease (MCI to Mild Dementia Due to AD)
Product: Amyvid 800 MBq/mL solution for injection, Amyvid 1900 MBq/mL solution for injection, Amyvid 800 MBq/mL solution for injection, [18F]MK-6240, Placebo Trontinemab, Amyvid 1900 MBq/mL solution for injection, Neuraceq 300 MBq/mL solution for injection, Trontinemab, VIZAMYL 400 MBq/mL solution for injection

Primary endpoint: Change from baseline to Week 72 in Clinical Dementia Rating, Sum of Boxes (CDR-SB)
Endpoint(s): Change from baseline through Week 72 in: ▪ Alzheimer’s Disease Assessment Scale-Cognition 13 (ADAS-Cog-13), Change from baseline through Week 72 in: ▪ Alzheimer’s Disease Cooperative Study Activities of Daily Living Inventory (ADCS-ADL) total score and instrumental score, Change from baseline through Week 72 in: ▪ Integrated Alzheimer’s Disease Rating Scale (iADRS), Change from baseline through Week 72 in: ▪ MMSE, Time to increase in CDR-GS, Nature, frequency, severity of adverse event (AEs) and serious adverse event (SAEs), Change from baseline in clinical laboratory assessments and vital signs, physical examinations (including neurological systems), Electrocardiogram (ECGs), and Columbia-Suicide Severity Rating Scale (C-SSRS), Nature, frequency, severity, and timing of ARIA-E and ARIA-H MRI findings, Nature, frequency, severity, and timing of Infusion-related reactions (IRRs), Incidence, onset and titer of anti-drug antibody (ADAs) to trontinemab during the study relative to the prevalence of ADAs at baseline, Change from baseline through Week 72 in brain amyloid load, as measured by amyloid positron emission tomography (PET) scan, Change from baseline to Week 72 in brain tau load, as measured by tau PET scan in a subset of participants, Change from baseline through Week 72 in cerebrospinal fluid (CSF) biomarkers of disease phosphorylated tau 181 (p-tau181), Neurogranin, amyloid-beta 42 (Aβ42), Aβ42/40 in a subset of participants, Change from baseline through Week 72 in blood biomarkers p-tau217, glial fibrillar acidic protein (GFAP), Aβ42, Aβ42/40

Source: https://euclinicaltrials.eu/ctis-public/view/2024-518006-40-00